EU clinical trial 2024-512701-11-00: An Open-label, Sequential, Ascending, Repeated Dose-finding Study of Sarilumab, Administered with Subcutaneous (SC) Injection, in Children and Adolescents, Aged 1 to 17 Years, with Systemic Juvenile Idiopathic Arthritis (sJIA), Followed by an Extension Phase. Name: SKYPS
Protocol code: DRI13926
Sponsor: Sanofi-Aventis Recherche & Developpement (Pharmaceutical company). Phase: Therapeutic exploratory (Phase II). Countries: Ireland (authorised, recruitment pending), Germany (ongoing, recruiting), Finland (ongoing, recruiting), Italy (ongoing, recruiting), Spain (ongoing, recruiting), Bulgaria (authorised, recruitment pending), France (ongoing, recruiting), Hungary (authorised, recruitment pending), Greece (authorised, recruitment pending), Romania (authorised, recruitment pending), Portugal (authorised, recruitment pending).
Therapeutic area(s): Diseases [C] - Immune System Diseases [C20]
Gender: Female, Male. Age: 0-17 years. Enrolment: 37.
Start date (EU): 2018-08-29. Decision date: 2024-07-17. Results received: No. Last updated: 2026-08-04.
Decision dates by country: DE: 2024-07-19, FI: 2024-07-19, IT: 2024-08-06, BG: 2024-07-18, FR: 2024-07-18, GR: 2026-01-09, ES: 2024-07-18, PT: 2026-01-21, HU: 2025-12-22, IE: 2024-07-17, RO: 2026-02-16

Condition(s): Systemic Juvenile Idiopathic Arthritis (sJIA)
Product: sarilumab

Primary endpoint: Assessment of PK parameter: maximum serum concentration observed (Cmax); Up to Week 12, Assessment of PK parameter: Area under the serum concentration versus time curve calculated using the trapezoidal method during a dose interval (AUC0-t); Up to Week 12, Assessment of PK parameter: Concentration observed before treatment administration during repeated dosing (Ctrough); Up to Week 12
Endpoint(s): Number of Adverse events; Core treatment phase: Up to Week 12, Extension phase:Up to Week 162, Acceptability assessments (local tolerability); Core treatment phase: Up to Week 12, Extension phase:Up to Week 156, Proportion of participants with Investigator Global Assessment (IGA) of disease activity below a defined value on 1-100 VAS scale. Core treatment phase: Up to Week 12 Extension phase:At weeks 24, 48, and every 24 weeks up to Week 156., Proportion of participants with Parent / patient Global Assessment (PGA) of well-being below a defined value on 1-100 VAS scale. Core treatment phase: Up to Week 12 Extension phase:At weeks 24, 48, and every 24 weeks up to Week 156., Assessment of participants with clinically inactive disease (CID). Core treatment phase: Up to Week 12 Extension phase: At weeks 24, 48, and every 24 weeks up to Week 156., Changes in glucocorticoid use. Core treatment phase: Up to Week 12 Extension phase:At weeks 24, 48, and every 24 weeks up to Week 156., Juvenile Idiopathic Arthritis ACR30/50/70/90/100 (in the absence of fever) response rate. Population according to the 2001 ILAR classification. Core treatment phase: Up to Week 12 Extension phase:At weeks 24, 48, and every 24 weeks up to Week 156., Change from baseline in individual JIA ACR components. Population according to the 2001 ILAR classification. Core treatment phase: Up to Week 12 Extension phase:At weeks 24, 48, and every 24 weeks up to Week 156., Change from baseline in Juvenile Arthritis Disease Activity Score-27 (JADAS). Population according to the 2001 ILAR classification. Core treatment phase: Up to Week 12 Extension phase: Up to Week 156., Assessment of participants with disease-related symptoms. Population according to the 2024 EULAR / PReS. At Week 4., Changes in IL-6 associated biomarkers. Population according to the 2001 ILAR classification and the 2024 EULAR / PReS. Up to week 12.

Source: https://euclinicaltrials.eu/ctis-public/view/2024-512701-11-00